EU clinical trial 2024-516318-40-02: HERES trial: Trastuzumab and standard treatment with chemo- and immunotherapy as first line treatment for HER2 positive esophageal squamous cell carcinoma patients
Sponsor: Rigshospitalet, Frederiksberg Hospital (Hospital/Clinic/Other health care facility). Phase: Therapeutic exploratory (Phase II). Countries: Denmark (ended).
Therapeutic area(s): Diseases [C] - Neoplasms [C04]
Gender: Female, Male. Age: 18-64 years, 65+ years. Enrolment: 24.
Status: Ended. Start date (EU): 2022-02-21. End date (EU): 2026-06-02. Decision date: 2024-11-29. Results received: No. Last updated: 2025-08-20.
Decision dates by country: DK: 2025-01-09

Condition(s): Esophageal Cancer
Product: FLUOROURACIL, PEMBROLIZUMAB, CAPECITABINE, OXALIPLATIN, CAPECITABINE, Trazimera 150 mg powder for concentrate for solution for infusion

Primary endpoint: If response in 12 out of 24 patients, the alternative hypothesis is accepted, and the drug is considered appropriate for further evaluation.

Source: https://euclinicaltrials.eu/ctis-public/view/2024-516318-40-02